EU clinical trial 2024-514652-33-00: MELFLUFEN FOR ELDERLY MYELOMA PATIENTS IN SECOND OR SUBSEQUENT RELAPSE (MELISSA)
Protocol code: MELISSA
Sponsor: Fondazione European Myeloma Network Italy O.N.L.U.S. (Patient organisation/association). Phase: Therapeutic exploratory (Phase II). Countries: Italy (not authorised).
Therapeutic area(s): Diseases [C] - Neoplasms [C04]
Gender: Female, Male. Age: 65+ years. Enrolment: 30.
Status: Not authorised. Decision date: 2025-02-12. Results received: No. Last updated: 2025-02-12.

Condition(s): Relapsed Multiple Myeloma
Product: SOLDESAM 0,2% gocce orali, soluzione, Pepaxti 20 mg powder for concentrate for solution for infusion, SOLDESAM 8 mg/2 ml soluzione iniettabile

Primary endpoint: It is the overall response rate anytime during the treatment period. Overall response rate (ORR) is defined as participants who achieve a PR or better (PR+VGPR+CR+sCR) according to IMWG response criteria during the treatment. The primary estimand is defined by the 5 components: Treatment, Population, Variable, Population-levels summary, Intercurrent event. It will be considered reached if >7 PR or better are present.Rate and the corresponding 90% Clopper-Pearson exact CI will be also provided.
Endpoint(s): Duration of response (DOR) is defined as the time from the date of first documented response (≥PR) to the date of first confirmed PD. If the participant is w/o progression disease, the participant’s data will be censored at the date of last disease assessment., Progression-free survival (PFS) is defined as the time from the date of 1st dose of study drug to the date of first confirmed PD, as defined in the IMWG response criteria, or death due to any cause, whichever occurs first. If the participant is alive and w/o progression disease, the participant’s data will be censored at the date of last disease assessment., Time to progression (TTP) is defined as the time from the date of 1st dose of study drug to the date of first documented PD, as defined in the IMWG response criteria. If the participant is w/o progression disease or die, the participant’s data will be censored at the date of last disease assessment., Progression free survival 2 (PFS2) is defined as the time from the date of 1st dose of study drug to the date of event, which is defined as death from any cause or PD as assessed by investigator that starts after the next line of therapy, whichever occurs first., Overall survival (OS) is defined as the time from the date of 1st dose of study drug to the date of death. If the participant is alive, the participant’s data will be censored at the date the participant was last known to be alive., Time to response (TTR) is defined as the time from the date of 1st dose of study drug to the first documented response (≥PR). If the participant is alive, w/o progression disease and w/o documented response (≥PR), the participant’s data will be censored at the date of last disease assessment. If the participant have a progression or die before a documented response (≥PR), the participant’s data will have a competing event at the date of PFS event.

Source: https://euclinicaltrials.eu/ctis-public/view/2024-514652-33-00